EU clinical trial 2023-505060-11-00: An Open-Label Multiple-Dose Study to Evaluate the Pharmacokinetics, Safety, and Tolerability of Upadacitinib in Pediatric Subjects with Polyarticular Course Juvenile Idiopathic Arthritis
Protocol code: M15-340
Sponsor: AbbVie Deutschland GmbH & Co. KG (Pharmaceutical company). Phase: Human Pharmacology (Phase I)- Other. Countries: Hungary (ongoing, recruitment ended), Germany (ongoing, recruitment ended), Spain (ongoing, recruitment ended), Italy (ongoing, recruitment ended), Sweden (ended).
Therapeutic area(s): Diseases [C] - Immune System Diseases [C20]
Gender: Female, Male. Age: 0-17 years. Enrolment: 104.
Start date (EU): 2019-06-19. Decision date: 2023-08-31. Results received: No. Last updated: 2026-03-10.
Decision dates by country: SE: 2023-08-31, DE: 2023-08-31, HU: 2023-08-31, ES: 2023-09-01, IT: 2023-09-06

Condition(s): Polyarticular Course Juvenile Idiopathic Arthritis
Product: Upadacitinib, Upadacitinib

Primary endpoint: The values for the pharmacokinetic parameters of upadacitinib including Cmax, time to maximum observed plasma concentration (Tmax), area under the plasma concentration versus time curve during a dosing interval (AUCtau) on Day 7, and apparent oral clearance at steady state (CL/F) will be determined using non-compartmental methods.
Endpoint(s): To evaluate the palatability of upadacitinib oral solution in pediatric subjects.

Source: https://euclinicaltrials.eu/ctis-public/view/2023-505060-11-00